EU clinical trial 2024-519382-22-00: A research study of a new medicine, NNC9733-0001, in healthy participants and participants with type 2 diabetes
Protocol code: NN9733-8133
Sponsor: Novo Nordisk A/S (Pharmaceutical company). Phase: Human Pharmacology (Phase I)- First administration to humans. Countries: Germany (ongoing, recruiting).
Therapeutic area(s): Diseases [C] - Nutritional and Metabolic Diseases [C18]
Gender: Female, Male. Age: 18-64 years. Enrolment: 72.
Status: Ongoing, recruiting. Start date (EU): 2025-11-10. Decision date: 2025-10-24. Results received: No. Last updated: 2025-10-24.

Condition(s): Healthy Participants and Participants with type 2 diabetes

Source: https://euclinicaltrials.eu/ctis-public/view/2024-519382-22-00